EU clinical trial 2024-513187-25-00: A phase-2b controlled study to evaluate the humoral and cellular immune response and safety following one and two doses of an adjuvanted RSV subunit vaccine in immunocompromised patients aged 18 years and older.
Protocol code: ISPTM-RSV-001
Sponsor: Medical University Of Vienna (Educational Institution). Phase: Therapeutic exploratory (Phase II). Countries: Austria (ongoing, recruiting).
Therapeutic area(s): Diseases [C] - Respiratory Tract Diseases [C08]; Diseases [C] - Virus Diseases [C02]
Gender: Female, Male. Age: 18-64 years, 65+ years. Enrolment: 200.
Status: Ongoing, recruiting. Start date (EU): 2024-09-10. Decision date: 2024-09-02. Results received: No. Last updated: 2025-07-14.

Condition(s): Respiratory syncytial virus
Product: SALINE, Arexvy powder and suspension for suspension for injection Respiratory Syncytial Virus (RSV) vaccine (recombinant, adjuvanted)

Primary endpoint: Fold increase of RSV-A and -B-specific neutralizing titers 30-60 days (V5) after the second dose relative to titers 30-60 days (V3) after the first dose in immunocompromised patients. Analysis will be performed by group and on the pooled immunocompromised patient.
Endpoint(s): RSV-A and -B-specific neutralizing antibody (NT) and PreF3-specific IgG (ELISA) levels from baseline to up to 12 months post last dose by group and on the pooled immunocompromised patients and in controls., RSV-A and -B-specific neutralizing antibody (NT) and PreF3-specific IgG (ELISA) increase above baseline (V1) at all visits (V2-V7) by group and on the pooled immunocompromised patients and in controls., Seroresponse rate (increase in NT/IgG ELISA) of participants per group at all post-first dose visits over baseline by group and on the pooled immunocompromised patients and in controls., Antibody decline (NT/IgG ELISA) after first and second dose of Arexvy in immunocompromised patients by group and on the pooled immunocompromised patients and in controls., Antibody decline (NT/IgG ELISA) after one dose of Arexvy the healthy control group ≥60 YoA., RSV-A and -B-specific neutralizing antibody (NT) and PreF3-specific IgG (ELISA) from baseline to 12 months post last dose in immunocompromised patients by group and on the pooled immunocompromised patients and in controls and compared to controls., RSV-A and -B-specific neutralizing antibodies and PreF3-specific IgG (ELISA) antibody decline after second dose in immunocompromised patients per group and pooled compared to decline in controls after first dose up to 12 months post last dose., Cytokine production after RSV PreF3-specific PBMC restimulation such as IFN-g and IL-2 (V1-V7) in immunocompromised patients per group and controls., Participants reporting solicited local and systemic AEs (up to 7 days post V1 and V3), Participants reporting unsolicited (up to 30 days post V1 and V3) adverse events, Participants reporting SAEs, and AEs of special interest (atrial fibrillation, pIMD) from patient notification during the whole study period., Cases of death after application of the first dose up to 12 months post last dose.

Source: https://euclinicaltrials.eu/ctis-public/view/2024-513187-25-00